EU clinical trial 2024-512106-26-02: A phase 1, randomized, double-blind, placebo-controlled study investigating the safety, tolerability, pharmacokinetics, and pharmacodynamics of single and multiple ascending doses of VNA-318 in healthy male subjects
Protocol code: VNA-318-01
Sponsor: Vandria S.A. (Pharmaceutical company). Phase: Human Pharmacology (Phase I)- First administration to humans. Countries: France (ended).
Therapeutic area(s): Diseases [C] - Nervous System Diseases [C10]
Gender: Male. Age: 18-64 years. Enrolment: 96.
Status: Ended. Start date (EU): 2024-11-19. End date (EU): 2025-11-12. Decision date: 2025-09-17. Results received: No. Last updated: 2025-10-10.

Condition(s): Cognitive impairment

Source: https://euclinicaltrials.eu/ctis-public/view/2024-512106-26-02